EU clinical trial 2023-504759-28-00: RANDOMIZED, OPEN LABEL, PARALLEL-GROUP, TWO-ARM, MULTICENTER STUDY WITH CLINICAL ENDPOINT COMPARING PRESERVATIVE FREE BIMATOPROST OPHTHALMIC SOLUTION 0.1 MG/ML AND LUMIGAN® (BIMATOPROST OPHTHALMIC SOLUTION) 0.1 MG/ML IN PATIENTS WITH CHRONIC OPEN-ANGLE GLAUCOMA OR OCULAR HYPERTENSION IN ONE OR BOTH EYES.
Protocol code: BIM-001
Sponsor: Genetic S.p.A. (Pharmaceutical company). Phase: Therapeutic confirmatory (Phase III). Countries: Italy (ended).
Therapeutic area(s): Diseases [C] - Eye Diseases [C11]
Gender: Female, Male. Age: 18-64 years, 65+ years. Enrolment: 124.
Status: Ended. Start date (EU): 2024-04-05. End date (EU): 2026-03-03. Decision date: 2024-02-14. Results received: No. Last updated: 2026-02-09.
Decision dates by country: IT: 2024-05-10

Condition(s): Ocular Hypertension, Chronic Open-angle Glaucoma
Product: BIMATOPROST 0.1 MG/ML,, LUMIGAN 0.1 mg/ml eye drops, solution

Primary endpoint: Difference in intraocular pressure (IOP) of one eye, (if both eyes have been treated only the contralateral right eye will be chosen) between the two treatment groups of the mean percentage reduction from baseline (V2) to day 42 (V5).
Endpoint(s): Efficacy: Reduction in IOP, at each follow-up time point, as compared with baseline, in the two study groups., Tolerability: Local tolerability assessed through Ocular Surface Disease Index (OSDI), Efron scale, Oxford scale, from baseline (V2) to day 42 (V5)., Safety: Quantitative and Qualitative Evaluation of Safety in terms of adverse events reported.

Source: https://euclinicaltrials.eu/ctis-public/view/2023-504759-28-00